EU clinical trial 2026-525350-11-00: A study to investigate a potential effect of rilzabrutinib (SAR444671) on ethinylestradiol and levonorgestrel from combined oral contraceptives in healthy female participants
Protocol code: INT22854
Sponsor: Sanofi-Aventis Recherche & Developpement (Pharmaceutical company). Phase: Human Pharmacology (Phase I)- Other. Countries: Germany (ongoing, recruiting).
Therapeutic area(s): Diseases [C] - Immune System Diseases [C20]
Gender: Female. Age: 18-64 years. Enrolment: 24.
Status: Ongoing, recruiting. Start date (EU): 2026-06-30. Decision date: 2026-05-11. Results received: No. Last updated: 2026-07-21.

Condition(s): Immune Thrombocytopenia Purpura

Source: https://euclinicaltrials.eu/ctis-public/view/2026-525350-11-00